EU clinical trial 2024-511440-76-00: Intralesional Cemiplimab for Adult Patients with Cutaneous Squamous Cell Carcinoma or Basal Cell Carcinoma
Protocol code: R2810-ONC-1787
Sponsor: Regeneron Pharmaceuticals Inc. (Pharmaceutical company). Phase: Human Pharmacology (Phase I)- First administration to humans. Countries: Netherlands (ended).
Therapeutic area(s): Diseases [C] - Neoplasms [C04]
Gender: Female, Male. Age: 18-64 years, 65+ years. Enrolment: 5.
Status: Ended. Start date (EU): 2025-03-20. End date (EU): 2025-12-10. End date: 2025-12-11. Decision date: 2024-09-05. Results received: No. Last updated: 2025-08-06.

Condition(s): Cutaneous Squamous Cell Carcinoma, Basal Cell Carcinoma

Source: https://euclinicaltrials.eu/ctis-public/view/2024-511440-76-00